EU clinical trial 2024-516036-94-00: MK-2400-01A Substudy: A Phase 1/2, Open-label Umbrella Substudy of MK-2400-U01 Master Protocol to Evaluate the Safety and Efficacy of Ifinatamab Deruxtecan-based Treatment Combinations or Ifinatamab Deruxtecan Alone in Participants With Metastatic Castration-resistant Prostate Cancer (mCRPC) (IDeate-Prostate02)
Protocol code: MK-2400-01A
Sponsor: Merck Sharp & Dohme LLC (Pharmaceutical company). Phase: Phase I and Phase II (Integrated)- Other. Countries: Spain (ongoing, recruiting), Poland (ongoing, recruiting), Netherlands (ongoing, recruiting), Italy (ongoing, recruiting), Germany (ongoing, recruiting), Ireland (ongoing, recruiting), France (ongoing, recruiting).
Therapeutic area(s): Diseases [C] - Neoplasms [C04]
Gender: Male. Age: 18-64 years, 65+ years. Enrolment: 145.
Status: Ongoing, recruiting. Start date (EU): 2025-08-12. Decision date: 2025-07-08. Results received: No. Last updated: 2026-05-21.
Decision dates by country: FR: 2025-07-08, IE: 2025-07-11, IT: 2025-07-08, PL: 2025-07-14, ES: 2025-07-09, NL: 2025-07-14, DE: 2025-07-08

Condition(s): Metastatic castrate resistant prostate cancer - mCRPC
Product: PREDNISONE, PARACETAMOL, FLUDROCORTISONE, ABIRATERONE, HYDROCORTISONE, Ifinatamab Deruxtecan, HYDROCORTISONE, HYDROCORTISONE, Opevesostat, DOCETAXEL, ENZALUTAMIDE, PREDNISOLONE

Primary endpoint: 1. Efficacy Phase: Number of Participants Who Experience One or More Dose-Limiting Toxicities (DLTs) - Combination Arms Only, 2. Efficacy Phase: Number of Participants Who Experienced an Adverse Event (AE), 3. Efficacy Phase: Number of Participants Who Discontinued Study Intervention Due to an AE, 4. Efficacy Phase: Prostate-Specific Antigen (PSA) response rate, 5. Safety Lead-in Phase: Number of Participants Who Experience One or More Dose-Limiting Toxicities (DLTs) - Combination Arms Only, 6. Safety Lead-in Phase: Number of Participants Who Experienced an Adverse Event (AE) - Combination Arms Only, 7. Safety Lead-in Phase: Number of Participants Who Discontinued Study Intervention Due to an AE - Combination Arms Only
Endpoint(s): Efficacy Phase: Objective Response Rate (ORR), Efficacy Phase: Radiographic Progression-Free Survival (rPFS), Efficacy Phase: Overall Survival (OS), Efficacy Phase: Duration of Response (DOR), Efficacy Phase: Time to First Subsequent Anticancer Therapy (TFST), Efficacy Phase: Time to Prostate-Specific Antigen (PSA) Progression, Efficacy Phase: Time to Pain Progression (TTPP)

Source: https://euclinicaltrials.eu/ctis-public/view/2024-516036-94-00